EU clinical trial 2024-516510-38-00: Mesenchymal stromal cells for traumatic brain injury. A multicenter, double blind, randomized, placebo-controlled phase II trial
Protocol code: MATRIx
Sponsor: Fondazione IRCCS San Gerardo Dei Tintori (Hospital/Clinic/Other health care facility). Phase: Therapeutic exploratory (Phase II). Countries: Italy (ongoing, recruiting).
Therapeutic area(s): Diseases [C] - Nervous System Diseases [C10]
Gender: Female, Male. Age: 18-64 years, 65+ years. Enrolment: 78.
Status: Ongoing, recruiting. Start date (EU): 2025-01-27. Decision date: 2025-01-27. Results received: No. Last updated: 2026-04-14.

Condition(s): Traumatic Brain Injury
Product: Placebo vials contain 4.5 ml of storage solution only (2.5 ml albumin 20%, 1.1 ml normal saline solution, 0.45 ml Citrate dextrose solution, 0.45 ml Dimethyl sulfoxide). Placebo and MSC vials are indistinguishable in appearance after thawing. There are no observable differences between treatments that could potentially compromise the blind., Mesenchymal stromal cells

Primary endpoint: 1. Safety. The number of patients experiencing at least one serious adverse drug reaction (SADR). 2. Biological activity. a) The number of responder patients, defined as in paragraph ”Statistical design and sample size” b) The quantitative plasmatic NfL at Day 14 as measured by ultra-sensitive single-molecule array immunoassay (SIMOA). The plasmatic NfL levels, as well as all secondary outcomes, will be only analyzed if at least one of the treatment arms will be considered as safe.
Endpoint(s): 1. Brain injury evolution and white matter damage by longitudinal advanced magnetic resonance imaging (MRI) (performed at 14 days +/- 3 days ,at 6 months +/- 15 days and 12 months +/- 15 days post-TBI)., 2. Brain immunomodulatory changes by temporal profiling of circulating biomarkers of: a) structural damage: NfL, glial fibrillary acidic protein (GFAP) b) neuroinflammation: interleukin-6 (IL-6), IL-10, tumor necrosis factor alpha (TNFα) c) vascular integrity: matrix metallopeptidase 9 (MMP-9), 3. Clinical outcome by a structured clinical and neuropsychological outcome assessment at both 6 and 12 months, by: a) Glasgow Outcome Scale Extended (GOSE) b) quality of life after brain injury (QOLIBRI) test

Source: https://euclinicaltrials.eu/ctis-public/view/2024-516510-38-00